EU clinical trial 2024-511640-11-00: A randomized phase III multicenter trial assessing efficacy and toxicity of a combination of Rituximab and Lenalidomide (R2) vs Rituximab alone as maintenance after chemoimmunotherapy with Rituximab-chemotherapy (R-CHT) for relapsed/refractory FL patients not eligible for autologous transplantation (ASCT)
Protocol code: FIL_Renoir12
Sponsor: Fondazione Italiana Linfomi Ets (Patient organisation/association). Phase: Therapeutic confirmatory (Phase III). Countries: Italy (ongoing, recruitment ended).
Therapeutic area(s): Diseases [C] - Hemic and Lymphatic Diseases [C15]
Gender: Female, Male. Age: 18-64 years, 65+ years. Enrolment: 160.
Status: Ongoing, recruitment ended. Start date (EU): 2014-05-15. Decision date: 2025-01-08. Results received: No. Last updated: 2025-06-12.

Condition(s): Follicular lymphoma
Product: RITUXIMAB, LENALIDOMIDE, RITUXIMAB, RITUXIMAB, RITUXIMAB

Primary endpoint: The primary endpoint will be the Progression-free Survival. PFS will be measured from the date of randomization to the date of documented first occurrence of disease progression or relapse or to the date of death from any cause. Patients without events considered and patients who are lost to follow up will be censored at their last assessment date.
Endpoint(s): OS will be measured from the date of randomization and from enrolment to the date of death from any cause. Patients who have not died at the time of the final analysis will be censored at the date of the last contact., Toxicity will be classified according to definitions of Common Terminology Criteria for Adverse Event latest version (CTCAE). It will be determined by the incidence of severe, life- threatening (CTCAE grade 3, 4 and 5) and/or serious adverse events (Infusion-related reactions)., Rate of molecular remission will be defined as the proportion of patients PCR negative for Bcl-2/IgH at different time-points including those achieving continuous MR in two or more consecutive time-points., Rate of molecular conversion will be defined as the proportion of patients from baseline PCR-positivity to PCR-negativity., Rate of molecular relapse will be defined as the proportion of patients from PCR-negativity to PCR-positivity., QoL will be measured at the baseline, the end of induction and at 6, 12 and 24 months of maintenance through the EORTC QLQ-C30 questionnaire.

Source: https://euclinicaltrials.eu/ctis-public/view/2024-511640-11-00